EU clinical trial 2024-519736-17-00: A phase 2, multi-center study consisting of a randomized, placebo-controlled period, followed by an open-label extension period to assess the efficacy, safety, and tolerability of tibulizumab in adults with hidradenitis suppurativa
Protocol code: ZB-106-HS-202
Sponsor: Zura Bio Inc. (Pharmaceutical company). Phase: Therapeutic exploratory (Phase II). Countries: Poland (ongoing, recruitment ended), Germany (ongoing, recruitment ended), Spain (ongoing, recruitment ended), Hungary (ongoing, recruitment ended).
Therapeutic area(s): Diseases [C] - Immune System Diseases [C20]
Gender: Female, Male. Age: 18-64 years, 65+ years. Enrolment: 90.
Status: Ongoing, recruitment ended. Start date (EU): 2025-10-03. Decision date: 2025-09-10. Results received: No. Last updated: 2026-05-05.
Decision dates by country: HU: 2025-09-12, DE: 2025-09-12, ES: 2025-09-10, PL: 2025-09-12

Condition(s): Hidradenitis Suppurativa
Product: Tibulizumab Placebo, Tibulizumab

Primary endpoint: Percentage change from baseline in abscess and inflammatory nodule (AN) count at Week 16
Endpoint(s): Achieving HiSCR50 at Week 16; Achieving HiSCR75 at Week 16, Absolute change from baseline in Dermatology Life Quality Index (DLQI) score at Week 16; Absolute change from baseline in Patient's Global Assessment of Hidradenitis Suppurativa (HS-PtGA) score at Week 16; Absolute change from baseline in skin pain numerical rating scale (NRS) at Week 16, Incidence and severity of treatment emergent adverse events (TEAEs); Absolute change from baseline in vital signs, electrocardiogram (ECG) parameters, and clinical laboratory results

Source: https://euclinicaltrials.eu/ctis-public/view/2024-519736-17-00